EU clinical trial 2023-509359-15-00: A Randomized, Multicenter, Open-Label, Phase 3 Study of Acalabrutinib (ACP-196) Versus Investigator’s Choice of Either Idelalisib Plus Rituximab or Bendamustine Plus Rituximab in Subjects with Relapsed or Refractory Chronic Lymphocytic Leukemia
Protocol code: ACE-CL-309
Sponsor: Acerta Pharma B.V. (Pharmaceutical company). Phase: Therapeutic confirmatory (Phase III). Countries: Croatia (ended), Poland (ongoing, recruitment ended), Hungary (ongoing, recruitment ended), Czechia (ongoing, recruitment ended).
Therapeutic area(s): Diseases [C] - Hemic and Lymphatic Diseases [C15]
Gender: Female, Male. Age: 18-64 years, 65+ years. Enrolment: 25.
Start date (EU): 2017-03-08. Decision date: 2024-10-30. Results received: No. Last updated: 2026-07-30.
Decision dates by country: HU: 2024-10-30, PL: 2024-10-31, CZ: 2024-10-31, HR: 2024-11-28

Condition(s): Relapsed or Refractory Chronic Lymphocytic Leukemia
Product: Calquence 100 mg hard capsules

Primary endpoint: The primary endpoint of the study is PFS (defined as the time from randomization until disease progression or death from any cause) as assessed by the IRC per IWCLL 2008 criteria.
Endpoint(s): INV-assessed PFS per IWCLL 2008 criteria., INV-assessed ORR (defined as the proportion of patients who achieve a best response of complete remission [CR], complete remission with incomplete bone marrow recovery [CRi], nodular partial remission [nPR], or partial remission [PR]) per IWCLL 2008 criteria., IRC-assessed ORR per IWCLL 2008 criteria., OS (defined as the time from randomization to the date of death due to any cause), PROs as measured by change in scores from baseline to each assessment in the FACIT-Fatigue (will no longer be collected as of Amendment 6.0)., INV- and IRC-assessed DOR (defined as the time from the first documentation of objective response to the earlier time of disease progression [assessed by the IRC per IWCLL 2008 criteria] or death from any cause), TTNT (defined as the time from randomization to institution of nonprotocol-specified treatment for CLL)

Source: https://euclinicaltrials.eu/ctis-public/view/2023-509359-15-00